EU clinical trial 2024-519335-42-01: A Phase 2, Multi-Center Study Consisting of a Randomized, Double-Blind, Placebo-Controlled Period, Followed by an Open-Label Extension Period, to Assess the Efficacy, Safety, and Tolerability of Tibulizumab in Adults with Systemic Sclerosis
Protocol code: ZB-106-SS-201
Sponsor: Zura Bio Inc. (Pharmaceutical company). Phase: Therapeutic exploratory (Phase II). Countries: Hungary (ongoing, recruitment ended), Romania (ongoing, recruitment ended), Poland (ongoing, recruitment ended), Spain (ongoing, recruitment ended).
Therapeutic area(s): Diseases [C] - Immune System Diseases [C20]
Gender: Female, Male. Age: 18-64 years, 65+ years. Enrolment: 37.
Status: Ongoing, recruitment ended. Start date (EU): 2025-12-22. Decision date: 2025-11-27. Results received: No. Last updated: 2026-08-03.
Decision dates by country: PL: 2025-11-30, HU: 2025-12-17, RO: 2025-12-19, ES: 2025-11-27

Condition(s): Systemic Sclerosis
Product: Tibulizumab Placebo, Tibulizumab

Primary endpoint: Period 1: Change from baseline at Week 24 in modified Rodnan Skin Score (mRSS), Period 2: Incidence of all treatment-emergent adverse events; change in baseline in vital signs, electrocardiogram (ECG) parameters, and clinical laboratory results
Endpoint(s): Period 1 and 2: Change from baseline at Week 24 in quantitative interstitial lung disease obtained with high-resolution quantitative tomography in the whole lung, Period 1: Change from baseline at Week 24 in forced vital capacity (mL), Period 1: Change from baseline at Week 24 in Health Assessment Questionnaire Disability Index, Period 1: Incidence of all treatment-emergent adverse events; Change from baseline in vital signs, electrocardiogram parameters, and clinical laboratory results, Period 2: Change from baseline at Week 52 in modified Rodnan Skin Score (mRSS)

Source: https://euclinicaltrials.eu/ctis-public/view/2024-519335-42-01